EU clinical trial 2022-501537-23-00: An open-label, single-arm, pilot study of Venetoclax in combination with 5 days Azacitidine in treatment-naïve subjects with acute myelogenous leukemia who are ≥18 years of age and not eligible for standard induction therapy (VENAZA-5S PILOT TRIAL)
Protocol code: VENAZA-5S
Sponsor: University of Leipzig (Educational Institution). Phase: Therapeutic exploratory (Phase II). Countries: Germany (ended).
Therapeutic area(s): Diseases [C] - Neoplasms [C04]
Gender: Female, Male. Age: 18-64 years, 65+ years. Enrolment: 45.
Status: Ended. Start date (EU): 2023-05-16. End date (EU): 2025-11-16. Decision date: 2023-03-01. Results received: No. Last updated: 2025-05-07.

Condition(s): Acute myeloid leukemia
Product: Venclyxto 100 mg film-coated tablets, Vidaza 25 mg/ml powder for suspension for injection

Primary endpoint: The primary outcome measure is the response rate defined as the rate of CR or CRi after up to 6 cycles of therapy (best response).
Endpoint(s): Rate of CR or CRi by the Initiation of Cycle 2, Rate of CR with partial hematologic recovery (CRh) after up to 6 cycles of therapy, Time from initiation of treatment (C1D1) until achievement of CR or CRi, Objective response rate (CR, CRh, CRi, MLFS), Event free survival (EFS), Overall survival (OS), Descriptive assessment of MRD levels on study treatment, Time to treatment discontinuation, Rate of patients with at least one treatment interruption, Delay of subsequent cycles, dose reductions or shortening/interruption of study drug administration, Duration of patient hospitalization, Quality of life (QoL) measured through EORTC QLQ-C30

Source: https://euclinicaltrials.eu/ctis-public/view/2022-501537-23-00